EU clinical trial 2023-504376-21-00: A Phase 1b study to evaluate the safety, pharmacokinetics, and anti-tumour activity of the Myc inhibitor OMO-103 administered intravenously in combination with different drugs in patients with advanced solid tumours
Sponsor: Peptomyc S.L. (Pharmaceutical company). Phase: Human Pharmacology (Phase I)- Other. Countries: Spain (ongoing, recruitment ended).
Therapeutic area(s): Diseases [C] - Neoplasms [C04]
Gender: Female, Male. Age: 18-64 years, 65+ years. Enrolment: 30.
Status: Ongoing, recruitment ended. Start date (EU): 2023-08-28. Decision date: 2023-07-24. Results received: No. Last updated: 2025-10-09.

Condition(s): pancreatic ductal adenocarcinoma

Source: https://euclinicaltrials.eu/ctis-public/view/2023-504376-21-00